EU clinical trial 2025-524936-20-00: A study comparing the new drugs PG511/PG521/PG531 produced by Celon Pharma SA with the drug PG203 in healthy volunteers.
Protocol code: 07PDE2026
Sponsor: Celon Pharma S.A. (Pharmaceutical company). Phase: Human Pharmacology (Phase I)- Bioequivalence Study. Countries: Poland (ongoing, recruiting).
Therapeutic area(s): Psychiatry and Psychology [F] - Mental Disorders [F03]; Diseases [C] - Nervous System Diseases [C10]
Gender: Female, Male. Age: 18-64 years. Enrolment: 68.
Status: Ongoing, recruiting. Start date (EU): 2026-07-20. Decision date: 2026-07-20. Results received: No. Last updated: 2026-07-20.

Condition(s): Treatment of psychotic disorders like schizophrenia Treatment of levodopa-induced dyskinesia in Parkinson's disease

Source: https://euclinicaltrials.eu/ctis-public/view/2025-524936-20-00